EU clinical trial 2024-511383-88-00: Phase II-III study to assess the efficacy and safety of subcutaneous cluster-immunotherapy in patients suffering from Olea europaea pollen allergy
Protocol code: SC-3C2A
Sponsor: ROXALL Medizin GmbH (Pharmaceutical company). Phase: Phase II and Phase III (Integrated). Countries: Spain (ended).
Therapeutic area(s): Diseases [C] - Immune System Diseases [C20]
Gender: Female, Male. Age: 18-64 years. Enrolment: 50.
Status: Ended. Start date (EU): 2024-09-01. End date (EU): 2025-10-14. End date: 2025-10-15. Decision date: 2024-07-11. Results received: No. Last updated: 2024-07-11.

Condition(s): Moderate-to-severe allergic rhinitis / rhinoconjunctivitis due to olive pollen for at least two years according to the Allergic Rhinitis and its Impact on Asthma (ARIA) guideline
Product: Mometasona cinfa 50 microgramos/pulverización Suspensión para pulverización nasal, CLU-RX-OLE high dose, Prick Test LETI Negativkontrolle Pricktestlösung, Placebo preparation for subcutanoues use with appearance, smell, taste and excipients identical to verum, but without the active substance, i. e. allergen extract., Provokations-Testlösung Esche 5.000 BE/ml Lyophilisat und Lösungsmittel, PRICK TEST Dermatophagoides pteronys- sinus LETI, 100 HEP/ml Pricktestlösung., PREDNISONA CINFA 10 MG COMPRIMIDOS, PRICK TEST Beifuss LETI, 30 HEP/ml Pricktestlösung., Mometasona furoato Kern Pharma 50 microgramos suspensión para pulverización nasal, Loratadina Kern Pharma 10 mg comprimidos EFG, PRICK TEST Lieschgras LETI, 30 HEP/ml Pricktestlösung, Hund Prick Test RX 20 µg/ml Pricktestlösung, Alternaria alternata Prick Test RX 3 µg/ml Pricktestlösung, Ragweed Prick Test RX 500 µg/ml Pricktestlösung, CLU-RX-OLE low dose, CLU-RX-OLE mid dose, Olivenbaum Prick Test RX 50 HEP/ml Pricktestlösung, Prednisona KERN PHARMA 10 mg comprimidos, Prick Test Histamin LETI Positivkontrolle 10 mg/ml Pricktestlösung, loratadina cinfa 10 mg comprimidos EFG, PRICK TEST Katzenepithel LETI, 30 HEP/ml Pricktestlösung.

Primary endpoint: The primary (efficacy) endpoint is defined as the absolute difference in mean CSMS (Combined Symptom and Medication Score) during Peak Olive Pollen Period (POPP) of each active treatment group compared to the placebo treatment group.
Endpoint(s): Absolute and relative differences in mean CSMS during OPS between active and placebo treatment groups., Absolute and relative differences in mean dSS during POPP and OPS., Absolute and relative differences in mean dMS during POPP and OPS., Global Rhinoconjunctivitis Discomfort with a Visual Analogue Scale (VAS)., Change in Rhinoconjunctivitis quality of life questionnaire (RQLQ) between active and placebo treatment groups comparing basal and post-treatment scoring., Well and severe days: A well day is defined as a day without administration of any rescue medication (dMS = 0) and with dSS < 0.34 (range 0-3). A severe day is defined (acc. to Pfaar et al. 2014) as a day with a single score = 3 in any of the six symptoms. Percentages of well and severe days will be calculated for each subject as the number of well or severe days in the POPP and OPS in relation to the number of days comprising both periods., Symptom-free days are defined as the days with the absence of symptoms (dSS = 0) and without administration of any rescue medication (dMS = 0), expressed as percentage of days during the POPP and OPS, tNPT titrated Nasal Provocation Test: To assess the efficacy of each dose of CLU-RX-OLE compared to placebo. Defined as the percentage of patients with an increased dosing step and the change in the number of dosing steps needed to provoke a positive response in the titrated nasal provocation test (tNPT) post-treatment compared with pre-treatment (i. e. any improvement) in each of the four study groups, To analyse the safety and tolerability of each dose of CLU-RX-OLE compared to placebo by Treatment-Emergent Adverse Drug Reactions (TEADR) and patients affected with TEADRs in each group.

Source: https://euclinicaltrials.eu/ctis-public/view/2024-511383-88-00